EU clinical trial 2024-513125-23-00: A Phase II, Randomized, Double-Blind, Placebo-Controlled Study of the Efficacy and Safety of GDC-8264 in preventing Cardiac Surgery-Associated Acute Kidney Injury and Major Adverse Kidney Events
Protocol code: GC45428
Sponsor: Genentech Inc. (Pharmaceutical company). Phase: Therapeutic exploratory (Phase II). Countries: Czechia (ended), Germany (ended), Belgium (ended), Netherlands (ended), France (ended), Spain (ended).
Therapeutic area(s): Diseases [C] - Cardiovascular Diseases [C14]
Gender: Female, Male. Age: 18-64 years, 65+ years. Enrolment: 175.
Status: Ended. Start date (EU): 2025-02-28. End date (EU): 2026-03-03. End date: 2026-03-04. Decision date: 2025-02-14. Results received: No. Last updated: 2026-02-05.
Decision dates by country: CZ: 2025-03-18, FR: 2025-02-18, BE: 2025-02-18, DE: 2025-02-18, ES: 2025-03-17, NL: 2025-03-20

Condition(s): Patients with moderate to high risk for cardiac surgery associated- acute kidney injury (CSA-AKI)
Product: Placebo: GDC-8264, GDC-8264, GDC-8264, GDC-8264

Primary endpoint: 1. Proportion of patients who develop MAKE90 defined as the occurrence of any of the following within 90 days after surgery: – Death – Requirement for dialysis – ≥ 25% decline in eGFR from baseline to Day 90 after surgery
Endpoint(s): 1. Proportion of patients who develop AKI, defined by the Kidney Disease Improving Global Outcomes (KDIGO) criteria within 7 days after surgery, 2. Change in eGFR from baseline to POD 30, 60, and 90, 3. Incidence of new CKD at POD 90 or worsened baseline CKD by Grade 1 or more within 90 days after surgery, including from Stage 3a to 3b, 4. Proportion of patients who develop MAKE30 (within 30 days after surgery) and MAKE60 (within 60 days after surgery), defined as the occurrence of any of the following: – Death – Requirement for dialysis – ≥ 25% decline in eGFR from baseline to Day 30 and Day 60 after surgery

Source: https://euclinicaltrials.eu/ctis-public/view/2024-513125-23-00